EU clinical trial 2024-518517-26-00: Tittle: Effects of intravenous administered iron in non-anemic iron deficient patients with colorectal cancer. A double blinded clinical randomized trial.
Sponsor: Region Sjaelland (Hospital/Clinic/Other health care facility). Phase: Therapeutic exploratory (Phase II). Countries: Denmark (ongoing, recruiting).
Therapeutic area(s): Diseases [C] - Digestive System Diseases [C06]
Gender: Female, Male. Age: 18-64 years, 65+ years. Enrolment: 134.
Status: Ongoing, recruiting. Start date (EU): 2024-10-10. Decision date: 2024-11-15. Results received: No. Last updated: 2024-11-15.

Condition(s): Iron deficiency
Product: Natriumchlorid ”Noridem”,solvens til parenteral anvendelse/injektionsvæske, opløsning, Monofer, injektions- og infusionsvæske, opløsning

Primary endpoint: Changes in cellular respiration (VO2max at the Anaerobic Threshold) measured by the gold standard Cardio Pulmonary Exercise Testing (CPET)., The preoperative change in the Neutrophil to Lymphocyte Ratio (NLR), The up and downregulation of immune function at the invasive front of the tumor, measured by the Nanostring™ PanCancer Immune® profiling panel
Endpoint(s): The patients subjective description of physical capacity measured by the Fatique Severity Score questionnaire, Treatment characteristics such as: Adverse events, serious adverse events, blood transfusions, changes in transferrin, ferritin, transferrin saturation, iron, hemoglobin and phosphate, length of stay, infectious complications measured by the comprehensive complication index and quality of recovery-15 during the admission, One and five year survival rates and recurrence rates.

Source: https://euclinicaltrials.eu/ctis-public/view/2024-518517-26-00